EU clinical trial 2023-508235-31-00: A Phase 3, 2-Part, Open-Label and Double-Blind, Randomised Study to Evaluate the Effectiveness and Safety of Lebrikizumab Treatment in Adults and Adolescents with Moderate-to-Severe Atopic Dermatitis
Protocol code: M-17923-34
Sponsor: Almirall S.A. (Pharmaceutical company). Phase: Therapeutic confirmatory (Phase III). Countries: Sweden (ongoing, recruitment ended), Austria (ongoing, recruitment ended), Denmark (ongoing, recruitment ended), Spain (ongoing, recruitment ended), France (ongoing, recruitment ended), Italy (ongoing, recruitment ended).
Therapeutic area(s): Diseases [C] - Skin and Connective Tissue Diseases [C17]
Gender: Female, Male. Age: 0-17 years, 18-64 years, 65+ years. Enrolment: 522.
Status: Ongoing, recruitment ended. Start date (EU): 2024-06-17. Decision date: 2024-05-13. Results received: No. Last updated: 2026-07-21.
Decision dates by country: DK: 2024-05-13, SE: 2024-05-16, IT: 2024-08-30, FR: 2024-08-05, AT: 2024-05-21, ES: 2024-05-13

Condition(s): Atopic Dermatitis
Product: Ebglyss 250 mg solution for injection in pre-filled syringe, Placebo, Ebglyss 250 mg solution for injection in pre-filled pen

Primary endpoint: PART 1 Percentage of participants achieving EASI score ≤7 at Week 24 PART 2 • Percentage of participants achieving EASI 75 at Week 36 • Percentage of participants with an IGA score of 0 or 1 and a reduction ≥2 points from baseline (Part 1) at Week 36
Endpoint(s): PART 1: Time to EASI score ≤7, PART 1: Percentage of participants achieving EASI ≤5, and EASI ≤3 at Week 24, PART 1: Percentage of participants achieving EASI 75 and EASI 90 at Week 24, PART 1: Percentage of participants with an IGA score of 0 or 1 and a reduction ≥2 points at Week 24, PART 1: Percentage of participants achieving SCORAD 75 and SCORAD 90 at Week 24, PART 1: Percentage change in mTLSS (hands) from baseline at Week 24 , in participants with AD of the hands at baseline, PART 1: Pruritus: Percentage of participants with Pruritus NRS ≥4 at baseline achieving ≥4-point improvement in Pruritus NRS from baseline at Week 24, PART 1: Quality of Life: Percentage of participants achieving DLQI/cDLQI 0-1 at Week 24, PART 1: Quality of Life: Percentage of participants with DLQI ≥4 at baseline achieving ≥4 point improvement in DLQI from baseline at Week 24, PART 1: Quality of Life: Percentage of participants with cDLQI ≥6 at baseline achieving ≥6 point improvement in cDLQI from baseline at Week 24, PART 1: Sleep Loss Due to Itch: Percentage of participants with a Sleep-Loss Scale of ≥2 points at baseline achieving ≥2-point improvement at Week 24, PART 1: Disease Control: Percentage of participants with POEM ≥4 at baseline achieving ≥4 point improvement in POEM from baseline at Week 24, PART 2: Percentage of participants achieving EASI scores ≤7 and ≤3 at Week 36, PART 2: Percentage of participants achieving EASI 90 at Week 36, PART 2: Percentage of participants with pruritus NRS ≥4 at baseline (Part 1) achieving ≥4-point improvement in Pruritus NRS at Week 36, PART 2: Pruritus: Percentage of participants with pruritus NRS 0 or 1 at Week 36, PART 2: Quality of Life: Percentage of participants achieving DLQI/cDLQI 0 or 1 at Week 36, PART 2: Quality of Life: Percentage of participants with DLQI ≥4 at baseline (Part 1) achieving ≥4 point improvement in DLQI at Week 36, PART 2: Quality of Life: Percentage of participants with cDLQI ≥6 at baseline (Part 1) achieving ≥6 point improvement in cDLQI at Week 36, PART 2: Sleep Loss Due to Itch: Percentage of participants with a Sleep-Loss Scale of ≥2 points at baseline (Part 1) achieving ≥2-point improvement at Week 36, PART 2: Disease Control: Percentage of participants with POEM ≥4 at baseline (Part 1) achieving ≥4 point improvement in POEM at Week 36

Source: https://euclinicaltrials.eu/ctis-public/view/2023-508235-31-00